EU clinical trial 2025-521926-13-00: Pharmacokinetic study of the use of Nefopam 30 mg tablet in patients suffering from acute pain in rheumatology - NEFOPAIN kinetics
Protocol code: 2022/0355/HP
Sponsor: Centre Hospitalier Universitaire Rouen (Hospital/Clinic/Other health care facility). Phase: Therapeutic use (Phase IV). Countries: France (authorised, recruitment pending).
Therapeutic area(s): Diseases [C] - Pathological Conditions, Signs and Symptoms [C23]
Gender: Female, Male. Age: 18-64 years, 65+ years. Enrolment: 29.
Status: Authorised, recruitment pending. Decision date: 2025-09-24. Results received: No. Last updated: 2026-01-20.

Condition(s): Hospitalized patient with acute rheumatological pain, requiring nefopam if necessary
Product: NEFOPAM VIATRIS 20 mg/2 ml, solution injectable, Nefopam Panpharma 30 mg, comprimé pelliculé

Primary endpoint: main PK parameters will be determined using PKAnalix 2024R1 software (MonolixSuite, Saclay, France). They will include terminal elimination half-life, maximum concentration (Cmax), time at maximum concentration (Tmax) and exposure, characterized by the area under the curve obtained using the trapezoidal method. Bbioavailability will be calculated as the ratio of the AUC between the oral and intravenous forms, normalized to the dose for each patient using the cross-over design
Endpoint(s): volume of distribution (Vd), maximum plasma concentration of the PO form (Cmax), time after intake for which the concentration is maximum (Tmax), terminal elimination half-life and bioavailability, and to highlight potential clinico-biological factors responsible for a variation in exposure. The flexibility of the modeling will then enable different doses to be simulated to determine the optimal dosages maximizing likelihood with the IV route.

Source: https://euclinicaltrials.eu/ctis-public/view/2025-521926-13-00